EU clinical trial 2024-513618-37-00: An Open-Label Extension Study of EryDex in Patients with Ataxia-Telangiectasia Following Participation in Study IEDAT-04-2022 (NEAT)
Protocol code: IEDAT-05-2024
Sponsor: Quince Therapeutics S.p.A. (Pharmaceutical company). Phase: Therapeutic confirmatory (Phase III). Countries: Denmark (ended), Norway (ended), Germany (ended), Italy (ended), Poland (ended), Spain (ended).
Therapeutic area(s): Diseases [C] - Congenital, Hereditary, and Neonatal Diseases and Abnormalities [C16]; Diseases [C] - Nervous System Diseases [C10]
Gender: Female, Male. Age: 0-17 years, 18-64 years. Enrolment: 58.
Status: Ended. Start date (EU): 2024-12-23. End date (EU): 2026-01-30. End date: 2026-01-31. Decision date: 2024-10-23. Results received: Yes. Last updated: 2026-02-09.
Decision dates by country: IT: 2024-10-25, ES: 2024-10-23, PL: 2024-10-28, NO: 2024-10-25, DE: 2024-10-24, DK: 2024-10-23

Condition(s): Ataxia Telangiectasia (A-T)
Product: Dexamethasone sodium phosphate for encapsulation into autoerythrocytes

Primary endpoint: Safety endpoint : assessment of treatment-emergent adverse events (TEAEs), including serious AEs, discontinuations due to AEs, changes in vital signs, laboratory parameters, physical and neurological examination findings, and the C-SSRS. Additionally, potential effects associated with the use of eDSP will be assessed by changes in cortisol, glucose, cluster of differentiation CD4+ lymphocyte count, bone mineral density obtained using energy x-ray absorptiometry (DEXA), and growth and development
Endpoint(s): Exploratory Endpoint Assessments: Evaluation of the effects of eDSP will be assessed by the International Cooperative Ataxia Rating Scale (ICARS), the modified ICARS (mICARS), and the Rescored mICARS (RmICARS).

Source: https://euclinicaltrials.eu/ctis-public/view/2024-513618-37-00